EU clinical trial 2025-522126-13-00: A Phase 1, Randomized, Double-Blind, Placebo-Controlled, Single Ascending Dose Tolerability, Pharmacokinetic, Pharmacodynamic, and Preliminary Efficacy Trial of GTX-B001 in Healthy Volunteers (Part A) and Patients with Chronic Inducible Urticaria (Part B)
Protocol code: CHILL-MC
Sponsor: Granular Therapeutics Limited (Pharmaceutical company). Phase: Human Pharmacology (Phase I)- First administration to humans. Countries: Germany (ongoing, recruiting).
Therapeutic area(s): Diseases [C] - Skin and Connective Tissue Diseases [C17]
Gender: Female, Male. Age: 18-64 years. Enrolment: 56.
Status: Ongoing, recruiting. Start date (EU): 2025-08-29. Decision date: 2025-08-27. Results received: No. Last updated: 2026-05-29.

Condition(s): Cold Induced Urticaria

Source: https://euclinicaltrials.eu/ctis-public/view/2025-522126-13-00